EU clinical trial 2024-516212-24-00: Frontline Asciminib combination in chronic phase CML
Protocol code: FASCINATION
Sponsor: Friedrich-Schiller-Universitaet Jena (Educational Institution). Phase: Therapeutic exploratory (Phase II). Countries: Germany (ongoing, recruitment ended).
Therapeutic area(s): Diseases [C] - Hemic and Lymphatic Diseases [C15]
Gender: Female, Male. Age: 18-64 years, 65+ years. Enrolment: 125.
Status: Ongoing, recruitment ended. Start date (EU): 2024-10-08. Decision date: 2024-10-08. Results received: No. Last updated: 2026-07-06.

Condition(s): Chronic Myeloid Leukemia
Product: ASCIMINIB

Primary endpoint: Rate of MR4 at month 12

Source: https://euclinicaltrials.eu/ctis-public/view/2024-516212-24-00